EU clinical trial 2024-515637-14-00: A Phase 3 Open-label Study Evaluating the Longterm Safety and Efficacy of Elexacaftor/Tezacaftor/Ivacaftor in Cystic Fibrosis Subjects With Non-F508del CFTR Genotypes
Protocol code: VX21-445-125
Sponsor: Vertex Pharmaceuticals Inc. (Pharmaceutical company). Phase: Therapeutic confirmatory (Phase III). Countries: Portugal (ongoing, recruitment ended), Belgium (ongoing, recruitment ended), Spain (ongoing, recruitment ended), Poland (ongoing, recruitment ended), Czechia (ongoing, recruitment ended), Norway (ended), Netherlands (ongoing, recruitment ended), Italy (ongoing, recruitment ended), Hungary (ongoing, recruitment ended), Sweden (ended), Germany (ended), France (ended), Austria (ongoing, recruitment ended).
Therapeutic area(s): Diseases [C] - Respiratory Tract Diseases [C08]
Gender: Female, Male. Age: 0-17 years, 18-64 years. Enrolment: 295.
Start date (EU): 2022-11-08. Decision date: 2024-10-17. Results received: No. Last updated: 2026-05-13.
Decision dates by country: AT: 2024-10-28, PL: 2024-11-08, DE: 2024-10-18, PT: 2024-10-23, NL: 2024-10-23, SE: 2024-10-17, BE: 2024-10-17, HU: 2024-10-18, NO: 2024-10-24, IT: 2024-10-22, FR: 2024-10-30, CZ: 2024-10-21, ES: 2024-10-18

Condition(s): Cystic Fibrosis
Product: Kalydeco 150 mg film-coated tablets, VX-770 Film-coated tablet, Kalydeco 75 mg film-coated tablets, VX-445/VX-661/VX-770 film-coated fixed-dose combination tablet, VX-770 Film-coated tablet, Kaftrio 37.5 mg/25 mg/50 mg film-coated tablets, VX-445/VX-661/VX-770 fixed-dose combination tablet, Kaftrio 75 mg/50 mg/100 mg film-coated tablets

Primary endpoint: Parts A and B: Safety and tolerability based on adverse events (AEs), clinical laboratory values, ECGs, vital signs, and pulse oximetry
Endpoint(s): Part A Only: Absolute change from baseline in percent predicted forced expiratory volume in 1 second (ppFEV1), Absolute change from baseline in sweat chloride (SwCl), Absolute change from baseline in Cystic Fibrosis Questionnaire-Revised (CFQ-R) respiratory domain (RD) score, Absolute change from baseline in body mass index (BMI), Absolute change from baseline in weight, Number of pulmonary exacerbations (PEx)

Source: https://euclinicaltrials.eu/ctis-public/view/2024-515637-14-00